EU clinical trial 2022-501884-41-00: (21181) A multicenter, randomized, prospective double-blind, cross over Phase 3 study to evaluate the efficacy and safety of 0.04 mmol Gd/kg body weight of gadoquatrane for MRI in adults with known or suspected pathology of the central nervous system (CNS), compared to 0.1 mmol Gd/kg approved macrocyclic gadolinium-based contrast agents (GBCAs)
Protocol code: 21181
Sponsor: Bayer AG (Pharmaceutical company). Phase: Therapeutic confirmatory (Phase III). Countries: Sweden (ended), France (ended), Bulgaria (ended), Italy (ended), Hungary (ended), Czechia (ended), Germany (ended).
Therapeutic area(s): Analytical, Diagnostic and Therapeutic Techniques and Equipment [E] - Diagnosis [E01]
Gender: Female, Male. Age: 18-64 years, 65+ years. Enrolment: 186.
Status: Ended. Start date (EU): 2023-09-29. End date (EU): 2024-12-17. End date: 2024-12-18. Decision date: 2023-09-13. Results received: Yes. Last updated: 2024-05-21.
Decision dates by country: HU: 2023-09-14, IT: 2023-09-18, SE: 2023-09-13, BG: 2023-09-18, CZ: 2023-09-13, DE: 2023-09-18, FR: 2023-12-04

Condition(s): Contrast enhancement in magnetic resonance imaging for assessment of central nervous system pathology
Product: GADOTERIC ACID, GADOBUTROL, GADOTERIDOL, BAY 1747846

Primary endpoint: 3 visualization parameters (enhancement on a 4PS, delineation on a 4PS, morphology on a 3PS) assessed by separate blinded evaluation of combined pre- and post- gadoquatrane MRI and combined pre- and post-comparator MRI with macrocyclic GBCAs, by a BICR
Endpoint(s): Sensitivity and specificity for the detection of lesions of combined pre- and post-gadoquatrane MRI and combined pre- and post-comparator MRI with macrocyclic GBCAs, by a BICR, 3 visualization parameters (enhancement on a 4PS, delineation on a 4PS, morphology on a 3PS) assessed by separate blinded evaluation of unenhanced and combined pre- and post-gadoquatrane MRI, by a BICR, The overall diagnostic clinical value of combined pre- and post- gadoquatrane MRI and combined pre- and post-comparator MRI with macrocyclic GBCAs, based on: i. the evaluation of diagnostic descriptive imaging features adapted from radiologic reporting standards (detection/exclusion of enhancing pathology; location, extent, and pattern of enhancement) on a 5PS (by the BICR and the Investigator; ii. the evaluation of patient management based on the diagnostic reporting recommendations (i.e., like, Sensitivity and specificity for the detection of malignant lesions of combined pre- and post-gadoquatrane MRI and combined pre- and post-contrastcomparator MRI with macrocyclic GBCAs assessed by BICR and the investigator, Describe the diagnoses from combined pre- and post- gadoquatrane MRI and combined pre- and post-comparator MRI with macrocyclic GBCAs by the Investigator, Confidence in diagnosis combined pre- and post-gadoquatrane MRI and combined pre- and post-comparator MRI with macrocyclic GBCAs by BICR and by Investigator on 4PS, Number of lesions seen on unenhanced MR image set and combined pre- and post-gadoquatrane MRI and combined pre- and post-comparator MRI with macrocyclic GBCAs, by a BICR, Number of enhancing lesions seen on combined pre- and post-gadoquatrane MRI and combined pre- and post-comparator MRI with macrocyclic GBCAs, by a BICR, Number and intensity of treatment emergent adverse events, including number of serious adverse events, after administration of gadoquatrane compared to macrocyclic GBCAs reported by the investigator during 24 ±4h p.i.

Source: https://euclinicaltrials.eu/ctis-public/view/2022-501884-41-00